EU clinical trial 2024-520286-31-00: A Study to Learn How Enzalutamide, Apalutamide and Bicalutamide Affect the Way Fezolinetant is Processed by the Body in Men With Prostate Cancer
Protocol code: 2693-CL-2101
Sponsor: Astellas Pharma Global Development Inc. (Pharmaceutical company). Phase: Human Pharmacology (Phase I)- Other. Countries: Bulgaria (authorised, recruitment pending).
Therapeutic area(s): Diseases [C] - Male Urogenital Diseases [C12]
Gender: Male. Age: 18-64 years, 65+ years. Enrolment: 56.
Status: Authorised, recruitment pending. Decision date: 2026-04-03. Results received: No. Last updated: 2026-07-31.

Condition(s): Hot Flush

Source: https://euclinicaltrials.eu/ctis-public/view/2024-520286-31-00